EU clinical trial 2025-525078-12-00: A randomized, balanced, two-treatment, two-sequence, single oral dose, two stage crossover adaptative bioequivalence study of Rifaximin 200 mg film-coated tablets (Antibiotice SA) vs. Normix® 200 mg, film- coated tablets (Alfasigma S.P.A) in healthy subjects under fed conditions
Protocol code: RIFAAIS 01-2025
Sponsor: Antibiotice S.A. (Pharmaceutical company). Phase: Human Pharmacology (Phase I)- Bioequivalence Study. Countries: Romania (authorised, recruitment pending).
Therapeutic area(s): Diseases [C] - Bacterial Infections and Mycoses [C01]; Diseases [C] - Digestive System Diseases [C06]
Gender: Female, Male. Age: 18-64 years. Enrolment: 64.
Status: Authorised, recruitment pending. Decision date: 2026-05-22. Results received: No. Last updated: 2026-05-22.

Condition(s): healthy subjects

Source: https://euclinicaltrials.eu/ctis-public/view/2025-525078-12-00